EU clinical trial 2024-516943-14-01: Bladder Preservation with Sacituzumab Govitecan + Zimberelimab for MuscleInvasive Bladder cancer in cisplatin-unfit and unwilling for cystectomy patients: phase II trial (preSAVE trial)
Protocol code: PreSave
Sponsor: Fondazione IRCCS Istituto Nazionale Dei Tumori (Hospital/Clinic/Other health care facility). Phase: Therapeutic exploratory (Phase II). Countries: Italy (authorised, recruitment pending).
Therapeutic area(s): Diseases [C] - Neoplasms [C04]
Gender: Female, Male. Age: 18-64 years, 65+ years. Enrolment: 62.
Status: Authorised, recruitment pending. Decision date: 2025-10-15. Results received: No. Last updated: 2025-10-15.

Condition(s): Muscle-Invasive Bladder cancer
Product: Zimberelimab, Trodelvy 200 mg powder for concentrate for solution for infusion

Primary endpoint: To assess event-free survival (EFS). Event’s components: clinical evidence of new or progressing nodal or any distant metastatic disease, radical cystectomy, or death due to any cause from date of inclusion to the first documentation of a EFS event. Patients last known to be EFS event-free are censored at the date of last event-free cystoscopy and/or CT scan. Those patients without disease assessment who are still alive will be censored at date of inclusion in the trial
Endpoint(s): To assess clinical or pathological downstaging after SG + Zimberelimab treatment, To assess efficacy and safety of SG + Zimberelimab in unfit and unwilling to cystectomy UC patients, To determine the predictive role of biomarkers in tissue and blood in patients who achieve clinical or pathological downstaging after SG + Zimberelimab treatment

Source: https://euclinicaltrials.eu/ctis-public/view/2024-516943-14-01